EU clinical trial 2025-522535-33-00: LOW DOse vs standard dose and administration TIme in near-infrared fluorescence cholangiography during laparoscopic cholecystectomy: a randomised clinical trial.
Protocol code: Low-DOTIG
Sponsor: Fundacion De Investigacion Biomedica De Salamanca (Laboratory/Research/Testing facility). Phase: Therapeutic use (Phase IV). Countries: Spain (ongoing, recruiting).
Therapeutic area(s): Diseases [C] - Digestive System Diseases [C06]
Gender: Female, Male. Age: 18-64 years, 65+ years. Enrolment: 122.
Status: Ongoing, recruiting. Start date (EU): 2026-02-13. Decision date: 2025-08-19. Results received: No. Last updated: 2025-12-09.
Decision dates by country: ES: 2025-11-19

Condition(s): Symptomatic Cholelithiasis
Product: INDOCYANINE GREEN

Primary endpoint: Rate of identification of biliary structures prior to dissection of the hepatocystic triangle., Rate of identification of biliary structures after dissection of the hepatocystic triangle., Degree of identification of extrahepatic biliary structures prior to dissection of the hepatocystic triangle (1 = poor, 2 = good, 3 = excellent)., Degree of identification of extrahepatic biliary structures after dissection of the hepatocystic triangle (1 = poor, 2 = good, 3 = excellent)., Perceived usefulness of fluorescence cholangiography during surgery (1 = not useful, 2 = moderately useful, 3 = very useful)., Perceived disturbance from background liver fluorescence (liver-to-duct contrast): 0 = none, 1 = slight, 2 = significant.
Endpoint(s): Analysis on the primary variables described above, corresponding to the predictors of the technique: sex, BMI, type of biliary pathology, type of surgery, previous inflammatory changes, degree of surgical difficulty, previous instrumentation and imaging systems., Analysis of intraoperative and postoperative complication rates of the technique, categorised by treatment group., Analysis of the relationship between surgical time and length of hospital stay.

Source: https://euclinicaltrials.eu/ctis-public/view/2025-522535-33-00